EU clinical trial 2024-516892-34-00: KF2024#1 trial: Esketamine interaction study
Sponsor: HUS-Yhtymae (Hospital/Clinic/Other health care facility). Phase: Human Pharmacology (Phase I)- Bioequivalence Study. Countries: Finland (ended).
Therapeutic area(s): Not possible to specify
Gender: Female, Male. Age: 18-64 years. Enrolment: 12.
Status: Ended. Start date (EU): 2024-12-03. End date (EU): 2025-04-29. Decision date: 2024-11-01. Results received: No. Last updated: 2024-11-06.
Decision dates by country: FI: 2024-11-06

Condition(s): healthy volunteers

Source: https://euclinicaltrials.eu/ctis-public/view/2024-516892-34-00